EU clinical trial 2023-507938-24-00: The effect of [18F]F-FAPI PET-CT on management in patients with potentially resectable biliary tract cancers: prospective multicenter study and cost-effectivity analysis.
Sponsor: Erasmus Universitair Medisch Centrum Rotterdam (Erasmus MC) (Hospital/Clinic/Other health care facility). Phase: Therapeutic confirmatory (Phase III). Countries: Netherlands (ongoing, recruiting).
Therapeutic area(s): Diseases [C] - Neoplasms [C04]
Gender: Female, Male. Age: 18-64 years, 65+ years. Enrolment: 81.
Status: Ongoing, recruiting. Start date (EU): 2024-11-29. Decision date: 2024-03-04. Results received: No. Last updated: 2024-09-16.

Condition(s): Cholangiocarcinoma
Product: [18F]-AlF-FAPI-74, GlucaGen®, HypoKit met 1 mg poeder en oplosmiddel voor oplossing voor injectie, Scopolamine butylbromide Kalceks 20 mg/ml oplossing voor injectie

Primary endpoint: sensitivity, specificity, positive predictive value, negative predictive value
Endpoint(s): True change and virtual change, Number of times readers’ conclusions differed, Cost-effectiveness analysis, budget impact analysis (BIA), sector costs, societal costs, health-related quality of life (HRQoL), Number of additional significant findings, Number of days between date of first imaging (CT/MRI) and starting date of chemotherapy, palliative therapy or surgical resection, The incidence and severity of AEs and SAEs according to CTCAEv5, Volume of interest (VOI), time to peak(TTP), K1 and K2, standardize uptake value (SUV), tumor-to-background ratio (TBR)

Source: https://euclinicaltrials.eu/ctis-public/view/2023-507938-24-00